EU clinical trial 2024-513653-75-00: E-merge - Evaluation of MEpolizumab-based regimen Compared to Conventional Therapeutic Strategy For Remission Induction In Patients With Eosinophilic Granulomatosis With Polyangiitis. Prospective, randomized, controlled, double-blind study
Protocol code: D20180135
Sponsor: Assistance Publique Hopitaux De Paris (Hospital/Clinic/Other health care facility). Phase: Therapeutic confirmatory (Phase III). Countries: France (ended).
Therapeutic area(s): Diseases [C] - Immune System Diseases [C20]
Gender: Female, Male. Age: 18-64 years, 65+ years. Enrolment: 100.
Status: Ended. Start date (EU): 2022-05-30. End date (EU): 2025-09-05. Decision date: 2024-10-04. Results received: No. Last updated: 2025-08-12.

Condition(s): Eosinophilic granulomatosis with polyangiitis (EGPA), formerly called Churg-Strauss syndrome
Product: Nucala 100 mg powder for solution for injection, IMUREL 25 mg, comprimé pelliculé, CYCLOPHOSPHAMIDE, SODIUM CHLORIDE, PLACEBO D AZATHIOPRINE

Primary endpoint: The percentage of patients who achieved a prednisone dose of 4.0 mg or less per day at day 168, without experiencing a relapse
Endpoint(s): Prednisone dosage at days 168 and 364, The area under the curve for corticosteroids at days 168 and 364 in the two treatment groups, Proportion of participants with a prednisone dose of 4.0 mg or less per day for 0 weeks, for more than 0 weeks but less than 4 weeks, for more than 4 weeks but less than 12 weeks, and for at least 12 weeks (categorical quantification), Proportion of participants with a prednisone dose of 4.0 mg or less per day at both days 168 and 364, Proportion of participants experiencing a relapse, Number of relapse during the study period, Number of asthma and sinonasal exacerbations during the study period, Time from inclusion to first relapse, The ACQ and SNOT-22 during the study period, The number of adverse events, expressed as adverse events according to the CTCAE toxicity grading system per patient-year at days 168 and 364 for the following adverse events combined: death (all causes), grade 2 or higher leukopenia or thrombocytopenia, grade 3 or higher infections, hemorraghic cystitis, malignancies, venous thromboembolic events, hospitalization resulting either from the disease or from a complication due to the study treatment, infusion reactions that result in the cessation, The Vasculitis Damage Index at days 168 and 364 in the two treatment groups, The HAQ and SF-36 at days 168 and 364 in the two treatment groups, Evolution of ANCA titers and eosinophils in the two treatment groups, and correlation with clinical events during follow-up

Source: https://euclinicaltrials.eu/ctis-public/view/2024-513653-75-00